EU clinical trial 2023-507485-10-00: MATRIX-IPC 2022-029 A phase I/II study evaluating Tuvusertib (M1774), an ATR Inhibitor, in combination with fulvestrant in hormone receptors-positive and HER2-negative, advanced breast cancers, resistant to CDK4/6 inhibitor plus aromatase inhibitor-based endocrine treatment and with homologous recombination deficiency, oncogenic driver activation and/or other molecular alterations associated with replication stress (RS)
Sponsor: Institut Paoli-Calmettes (Hospital/Clinic/Other health care facility). Phase: Phase I and Phase II (Integrated)- Other. Countries: France (authorised, recruiting).
Therapeutic area(s): Diseases [C] - Neoplasms [C04]
Gender: Female, Male. Age: 18-64 years, 65+ years. Enrolment: 57.
Status: Authorised, recruiting. Start date (EU): 2026-04-21. Decision date: 2024-04-05. Results received: No. Last updated: 2026-03-27.

Condition(s): advanced breast cancer
Product: FULVESTRANT, M1774 50mg, M1774 30mg

Primary endpoint: incidence of dose-limiting toxicity
Endpoint(s): Tolerance: incidence of AEs and Serious Adverse Events (SAE) presented by grade according to the NCI-CTCAE v5.0., overall response rate (ORR) as defined as the percent of patients with a complete response (CR) or a partial response (PR) (RECIST v1.1)., The progression-free survival (PFS) as defined as the interval between the date of inclusion and the date of progression or death. A patient alive and without progression will be censored at the last date of follow-up., PK evaluation will be performed on typical individual pharmacokinetics parameters (

Source: https://euclinicaltrials.eu/ctis-public/view/2023-507485-10-00